EU clinical trial 2022-501423-25-00: A study to see how well CVGBM vaccine works at different doses and how safe it is in patients who had surgery for glioblastoma or astrocytoma
Protocol code: CV-GBLM-001
Sponsor: Curevac AG (Pharmaceutical company). Phase: Phase I and Phase II (Integrated)- First administration to humans. Countries: Germany (ended), Netherlands (ended), Belgium (ended).
Therapeutic area(s): Diseases [C] - Neoplasms [C04]
Gender: Female, Male. Age: 18-64 years, 65+ years. Enrolment: 54.
Status: Ended. Start date (EU): 2023-05-05. End date (EU): 2026-02-02. Decision date: 2023-03-24. Results received: No. Last updated: 2025-09-15.
Decision dates by country: BE: 2023-03-27, NL: 2023-03-27, DE: 2023-03-24

Condition(s): Surgically Resected Glioblastoma (GBM) or Astrocytoma with a Molecular Signature of Unmethylated Glioblastoma

Source: https://euclinicaltrials.eu/ctis-public/view/2022-501423-25-00